EU clinical trial 2025-522209-40-00: A Study to Assess Adverse Events, Change in Disease Activity and How Intravenous (IV) ABBV901 Moves Through the Body Alone or in Combination with Bevacizumab in Adult Participants with Ovarian Cancer
Protocol code: M25-760
Sponsor: AbbVie Deutschland GmbH & Co. KG (Pharmaceutical company). Phase: Human Pharmacology (Phase I)- First administration to humans. Countries: Portugal (authorised, recruitment pending), Denmark (authorised, recruitment pending), Spain (authorised, recruitment pending), France (authorised, recruitment pending).
Therapeutic area(s): Diseases [C] - Neoplasms [C04]
Gender: Female, Male. Age: 18-64 years, 65+ years. Enrolment: 44.
Status: Authorised, recruitment pending. Decision date: 2026-07-27. Results received: No. Last updated: 2026-08-03.
Decision dates by country: FR: 2026-07-27, PT: 2026-07-29, DK: 2026-07-29, ES: 2026-08-03

Condition(s): Ovarian Cancer

Source: https://euclinicaltrials.eu/ctis-public/view/2025-522209-40-00